EU clinical trial 2025-524256-64-00: The impact of extra-fine inhalation corticosteroid particles on small-airway disease in Chronic Obstructive Pulmonary Disease (COPD): a randomized, prospective cross-over trial.
Sponsor: CHU Saint Pierre (Hospital/Clinic/Other health care facility). Phase: Therapeutic use (Phase IV). Countries: Belgium (authorised, recruitment pending).
Therapeutic area(s): Diseases [C] - Respiratory Tract Diseases [C08]
Gender: Female, Male. Age: 18-64 years, 65+ years. Enrolment: 60.
Status: Authorised, recruitment pending. Decision date: 2026-01-19. Results received: No. Last updated: 2026-01-19.

Condition(s): Chronic Obstructive Pulmonary Disease

Source: https://euclinicaltrials.eu/ctis-public/view/2025-524256-64-00